EU clinical trial 2022-501421-20-00: A Randomized, Multi-regional, Double-blind, Double-dummy Parallel-group, Placebo and Allopurinol-controlled Phase 3 Study to Assess the Efficacy and Safety of Tigulixostat in Gout Patients with Hyperuricemia
Protocol code: LG-GDCL010
Sponsor: LG Chem Ltd. (Pharmaceutical company). Phase: Therapeutic confirmatory (Phase III). Countries: France (ended), Italy (ended), Poland (ended), Czechia (ended), Belgium (ended), Lithuania (ended), Germany (ended), Spain (ended), Bulgaria (ended).
Therapeutic area(s): Diseases [C] - Nutritional and Metabolic Diseases [C18]; Diseases [C] - Musculoskeletal Diseases [C05]; Diseases [C] - Pathological Conditions, Signs and Symptoms [C23]
Gender: Female, Male. Age: 18-64 years, 65+ years. Enrolment: 690.
Status: Ended. Start date (EU): 2024-04-09. End date (EU): 2025-04-30. End date: 2025-05-06. Decision date: 2023-12-12. Results received: Yes. Last updated: 2025-06-06.
Decision dates by country: CZ: 2023-12-13, DE: 2023-12-12, IT: 2023-12-15, LT: 2023-12-18, FR: 2023-12-15, PL: 2023-12-14, BE: 2023-12-15, BG: 2023-12-18, ES: 2023-12-15

Condition(s): Gout with hyperuricemia
Product: Allopurinol OE Capsule, COLCHICINE, Tigulixostat 200 mg Placebo Tablet, NAPROXEN, Tigulixostat, Allopurinol Placebo Capsules, Tigulixostat, Tigulixostat 100 mg Placebo Tablet, Allopurinol OE Capsule, Allopurinol OE Capsule

Primary endpoint: Proportion of subjects with sUA levels <6.0 mg/dL sustained at Months 4, 5, and 6.
Endpoint(s): Proportion of subjects with sUA levels <5.0 mg/dL sustained at Months 4, 5, and 6., Proportion of subjects with at least one gout flare from Month 6 to Month 12., Proportion of subjects with complete resolution (100% resolution of at least one target tophus, no new tophi appearing, and no single tophus showing progression) of ≥1 target tophus by Month 12., Adverse Events (AEs)., Serious adverse events (SAEs)., Treatment-Emergent Adverse events (TEAEs)., Adverse Events of Special Interest (AESI) including MACE, hepatic injury, renal events, and serious skin and hypersensitivity reactions., Physical examinations, vital signs, clinical safety laboratory parameters, or ECGs.

Source: https://euclinicaltrials.eu/ctis-public/view/2022-501421-20-00